EU clinical trial 2023-505085-28-00: A PHASE 1 STUDY TO ASSESS THE MASS BALANCE, PHARMACOKINETICS, AND METABOLISM OF ORAL [14C]-ZIPALERTINIB IN HEALTHY ADULT MALE SUBJECTS
Protocol code: TAS6417-102
Sponsor: Taiho Oncology Inc. (Pharmaceutical company). Phase: Human Pharmacology (Phase I)- Other. Countries: Netherlands (ended).
Therapeutic area(s): Diseases [C] - Neoplasms [C04]
Gender: Male. Age: 18-64 years, 65+ years. Enrolment: 8.
Status: Ended. Start date (EU): 2023-07-05. End date (EU): 2023-08-23. End date: 2023-08-23. Decision date: 2023-06-09. Results received: Yes. Last updated: 2023-06-09.

Condition(s): Cancer
Product: [14C]ZIPALERTINIB

Primary endpoint: Mass balance will be calculated as the sum of the percent of total radioactivity (TRA) recovered in urine and feces relative to the administered radioactive dose minus any radioactivity lost due to emesis (if any occurred): Aeurine, Aefeces, Aetotal, feurine, fefeces, fetotal, TRA concentration equivalents in plasma and whole blood and the following pharmacokinetics (PK) parameters: AUC0-last, AUC0-inf, Cmax, Tmax, t½, and time matched AUC0-t (where t is the last common time point at which both TRA concentration equivalents and plasma zipalertinib concentrations are quantifiable in all subjects), Zipalertinib concentrations in plasma and the PK parameters: AUC0-last, AUC0 inf, Cmax, Tmax, Kel, t½, AUC0-t, CL/F, and Vz/F, Ratio of plasma zipalertinib to TRA at time-matched AUC0-t, Zipalertinib concentrations in urine, and the following PK parameters: CLR, Aeurine and feurine, The fraction of 14C radioactivity associated with cellular components in whole blood will be determined by using the 14C radioactivity concentrations in whole blood and plasma, and the whole blood:plasma concentration ratio will be calculated
Endpoint(s): Safety endpoints will include adverse events (AEs), vital signs measurements, 12-lead ECGs, clinical laboratory tests, and physical examination findings, Zipalertinib metabolic profiling and identification in plasma, urine, and feces containing sufficient amounts of radioactivity, and the percentage of each identified metabolite to TRA in plasma

Source: https://euclinicaltrials.eu/ctis-public/view/2023-505085-28-00